EU clinical trial 2023-503719-13-00: A randomized, double-blind, multi-center, placebo-controlled, parallel-group phase 3 study to compare the efficacy, acceptability, and safety of Tranexamic Acid Oral Solution 5% with placebo in the prevention of clinically relevant bleeding events in subjects treated with direct oral anticoagulants or vitamin K antagonists and undergoing a single or multiple tooth extraction
Protocol code: HYL-P004-003
Sponsor: Hyloris Developments (Pharmaceutical company). Phase: Therapeutic confirmatory (Phase III). Countries: Spain (ongoing, recruiting), Hungary (ended), Croatia (ongoing, recruiting), Romania (ongoing, recruiting).
Therapeutic area(s): Diseases [C] - Stomatognathic Diseases [C07]
Gender: Female, Male. Age: 18-64 years, 65+ years. Enrolment: 282.
Start date (EU): 2024-05-06. Decision date: 2023-10-30. Results received: No. Last updated: 2026-04-06.
Decision dates by country: HU: 2023-11-06, HR: 2023-11-03, RO: 2023-11-06, ES: 2023-10-30

Condition(s): Prevention of clinically relevant bleeding events in patients treated with direct anticoagulants or vitamin K antagonists and undergoing a single or multiple tooth extraction
Product: Placebo matching with Tranexamic Acid Oral Solution 5% of Hyloris Developments SA, Belgium, Tranexamic Acid Oral Solution 5%

Primary endpoint: Number of clinically relevant postoperative oral bleeding episodes (including clinically relevant orofacial hematomas) in all subjects
Endpoint(s): Number of postoperative oral bleeding episodes (including clinically and not clinically relevant bleedings and orofacial hematomas) in all subjects., Number of delayed postoperative oral bleeding episodes, both clinically relevant and not clinically relevant, in all subjects., Number of early (less than 24 h post-tooth extraction) postoperative oral bleeding episodes, both clinically relevant and not clinically relevant, in all subjects, Perioperative and immediate post-operative (procedural bleeding) duration (min, all types of oral bleeding)., Medication Acceptability Questionnaire (MAQ) for Tranexamic Acid Oral Solution 5% use completed in all subjects

Source: https://euclinicaltrials.eu/ctis-public/view/2023-503719-13-00